EU clinical trial 2024-516195-15-00: Dose tapering and Early Discontinuation to InCreAse cosT-effictIveness Of immunotherapy for Non-small cell lung carcinoma trial number 1 (NVALT-30 - Dedication-1)
Protocol code: 108439
Sponsor: Stichting Radboud universitair medisch centrum (Hospital/Clinic/Other health care facility). Phase: Therapeutic confirmatory (Phase III). Countries: Netherlands (ongoing, recruitment ended).
Therapeutic area(s): Diseases [C] - Respiratory Tract Diseases [C08]
Gender: Female, Male. Age: 18-64 years, 65+ years. Enrolment: 750.
Status: Ongoing, recruitment ended. Start date (EU): 2024-09-10. Decision date: 2024-09-10. Results received: No. Last updated: 2025-10-29.

Condition(s): Advanced NSCLC
Product: KEYTRUDA 25 mg/mL concentrate for solution for infusion

Primary endpoint: The primary study parameter is the overall survival rate at one year.

Source: https://euclinicaltrials.eu/ctis-public/view/2024-516195-15-00